EU clinical trial 2025-521966-91-00: An Open-label, Randomized, Multi-Center Study to Evaluate the Efficacy and Safety of Induction Treatment with Melphalan/HDS Followed by Consolidation Treatment with Eribulin or Vinorelbine or Capecitabine Versus Eribulin or Vinorelbine or Capecitabine Alone in Patients with Metastatic Breast Cancer with Liver Dominant Disease
Protocol code: PHP-MBC-202
Sponsor: Delcath Systems Inc. (Pharmaceutical company). Phase: Therapeutic exploratory (Phase II). Countries: Italy (ongoing, recruiting), Spain (authorised, recruitment pending), Sweden (authorised, recruitment pending), France (authorised, recruitment pending), Germany (authorised, recruitment pending).
Therapeutic area(s): Diseases [C] - Neoplasms [C04]
Gender: Female, Male. Age: 18-64 years, 65+ years. Enrolment: 24.
Start date (EU): 2026-03-31. Decision date: 2026-02-04. Results received: No. Last updated: 2026-07-23.
Decision dates by country: IT: 2026-02-04, ES: 2026-02-06, SE: 2026-07-06, FR: 2026-06-26, DE: 2026-07-23

Condition(s): Refractory Metastatic Breast Cancer with Liver Dominant Disease
Product: HALAVEN 0.44 mg/ml solution for injection, Xeloda 500 mg film-coated tablets, Vinorelbina Aurobindo 10 mg/ml concentrato per soluzione per infusione., Xeloda 150 mg film-coated tablets, Vinorelbina Aurobindo 10 mg/ml concentrato per soluzione per infusione., MELPHALAN HIKMA 50 mg/10ml, poudre et solvant pour solution injectable / pour perfusion

Primary endpoint: Hepatic progression free survival (hPFS)
Endpoint(s): Progression free survival (PFS), Overall response rate (ORR) (complete response [CR] + partial response [PR]), Hepatic ORR (hORR), Duration of response (DOR), Hepatic DOR (hDOR), Disease control rate (DCR), Hepatic DCR (hDCR), Overall survival (OS)

Source: https://euclinicaltrials.eu/ctis-public/view/2025-521966-91-00